EU clinical trial 2024-519224-24-00: Methadone versus fentanil and oxycodone for post-operative pain reduction in patients undergoing coronary artery bypass grafting and/or valve surgery – a placebo-controlled, double-blind, randomized clinical trial
Protocol code: 4000
Sponsor: Rigshospitalet (Hospital/Clinic/Other health care facility). Phase: Therapeutic use (Phase IV). Countries: Denmark (authorised, recruitment pending).
Therapeutic area(s): Diseases [C] - Cardiovascular Diseases [C14]; Analytical, Diagnostic and Therapeutic Techniques and Equipment [E] - Anesthesia and Analgesia [E03]
Gender: Female, Male. Age: 18-64 years, 65+ years. Enrolment: 110.
Status: Authorised, recruitment pending. Decision date: 2025-01-10. Results received: No. Last updated: 2026-07-30.

Condition(s): Following heart surgery, patients experience poor postoperative pain control and a moderate/high opioid consumptions. This is correlated to adverese events and poor outcome.
Product: Fentanyl "B. Braun" 50 mikrogram/ml injektionsvätska, lösning, Natriumklorid isotonisk "SAD", injektionsvæske, opløsning, METHADONE, Lindoxa, injektions-/infusionsvæske, opløsning

Primary endpoint: The primary endpoint will be cumulated intravenous morphineequivalent consumption within 48 hours from surgery
Endpoint(s): Pain intensity assessed by the Numeric Rating Scale (NRS) at rest and at cough., Pain intensity assessed by the Numeric Rating Scale (NRS) during physiotherapeutic testing, Time from arrival in CICU until patient extubating and mobilization., CICU Length of stay (time from arrival at CICU until booking of transfer to the ward), Days until bowel function (movement, Flatus, stool), Quality of Recovery 1516 at postoperative day 0, CICU discharge, 2, 30., Time to hospital discharge., 30 days mortality, Reported occurrence of postoperative arrythmias

Source: https://euclinicaltrials.eu/ctis-public/view/2024-519224-24-00